EU clinical trial 2024-512024-10-01: PROTamine Application in patients underGOing tRAnScatheter aortic valve replacement (PROTAGORAS)
Sponsor: Klinikum der Universitaet Muenchen AöR (Hospital/Clinic/Other health care facility). Phase: Therapeutic confirmatory (Phase III). Countries: Germany (ongoing, recruiting), Austria (authorised, recruitment pending).
Therapeutic area(s): Diseases [C] - Cardiovascular Diseases [C14]
Gender: Female, Male. Age: 18-64 years, 65+ years. Enrolment: 954.
Start date (EU): 2025-03-28. Decision date: 2025-01-24. Results received: No. Last updated: 2026-07-07.
Decision dates by country: DE: 2025-01-24, AT: 2026-06-04

Condition(s): Adult patients with severe aortic stenosis scheduled for transfemoral TAVR
Product: Sodium chloride 0.9 %, Protaminsulfat LEO Pharma 1400 Heparin-Antidot I.E./ml Injektionslösung und Infusionslösung

Primary endpoint: Primary and key secondary endpoints (hierarchical testing) are: Primary: Bleeding grade ≥type 2 (VARC) until 60h post TAVR procedure (superiority); Key secondary: Major ischemic events until 60h post procedure (non-inferiority) defined as the composite of Cardiovascular mortality, Myocardial infarction, Ischemic stroke, Major ischemic vascular complications
Endpoint(s): • Index-hospital mortality, • All-cause mortality at 30 days post TAVR procedure, • Bleeding grade type 1 (VARC) until 60h post TAVR procedure, • Unplanned cardiac or vascular surgery at 30 days post TAVR procedure, • Minor vascular complications until 60h post TAVR procedure, • Mean aortic valve gradient measured by transthoracic echocardiography (TTE) until 60h post TAVR procedure, • Delta mean aortic valve gradient (before TAVR vs. post TAVR procedure) measured by TTE until 60h post TAVR procedure, • Evidence of subclinical TAVR valve thrombosis until 60h post TAVR procedure, • Analysis of patients with and without oral anticoagulation with respect to the primary endpoint, • Analysis of patients with single vs. dual antiplatelet therapy with respect to the primary endpoint, • Analysis of different vascular closure devices with respect to the primary endpoint, • Analysis of different sheath sizes with respect to the primary endpoint, • Maximal drop of hemoglobin level from admission until follow-up until 60h post TAVR procedure, • Amount of red blood cell transfusions until 60h post TAVR procedure, • Performance of percutaneous transluminal angioplasty of access site until 60h post TAVR procedure, • Sex-specific analysis of the primary composite endpoint as well as its components, • Sex-specific analysis of all secondary endpoints, • Change of baseline NYHA class at 30 days post TAVR procedure, • Length of hospital stay after TAVR procedure

Source: https://euclinicaltrials.eu/ctis-public/view/2024-512024-10-01